EU clinical trial 2023-504916-14-00: AZ-3102: Protocol AZA-001-31-02: An open-label, single-dose phase 1 study to evaluate the Absorption, Metabolism, and Excretion of [14C]-AZ-3102 in Healthy Male Subjects
Protocol code: AZA-001-31-02
Sponsor: Azafaros B.V. (Pharmaceutical company). Phase: Human Pharmacology (Phase I)- Other. Countries: Netherlands (ended).
Therapeutic area(s): Diseases [C] - Nutritional and Metabolic Diseases [C18]
Gender: Male. Age: 18-64 years, 65+ years. Enrolment: 7.
Status: Ended. Start date (EU): 2023-07-13. End date (EU): 2023-08-25. Decision date: 2023-06-21. Results received: Yes. Last updated: 2023-06-21.

Condition(s): Glycosphingolipid lysosomal storage disorders

Primary endpoint: TOLERABILITY/SAFETY ENDPOINTS • Treatment-emergent AEs from study treatment administration until EOS., TOLERABILITY/SAFETY ENDPOINTS • Treatment-emergent serious adverse events (SAEs) from study treatment administration until EOS., TOLERABILITY/SAFETY ENDPOINTS • Abnormal safety laboratory findings, abnormal vital signs, and abnormal ECG parameters from study treatment administration until EOS., Pharmacokinetic endpoints: See protocol

Source: https://euclinicaltrials.eu/ctis-public/view/2023-504916-14-00